EU clinical trial 2024-510625-25-00: Evaluation of the benefit and safety of Localized Tissue Hydration (LTH) in the management of chronic common low back pain: Non-randomized single-center phase II study
Sponsor: Groupement De Cooperation Sanitaire Ramsay Generale De Sante Pour L'enseignement Et La Recherche (Laboratory/Research/Testing facility). Phase: Therapeutic exploratory (Phase II). Countries: France (ended).
Therapeutic area(s): Diseases [C] - Musculoskeletal Diseases [C05]
Gender: Female, Male. Age: 18-64 years, 65+ years. Enrolment: 29.
Status: Ended. Start date (EU): 2024-11-14. End date (EU): 2026-03-31. Decision date: 2024-05-29. Results received: No. Last updated: 2025-02-28.

Condition(s): chronic common low back pain
Product: CHLORURE DE SODIUM FRESENIUS 0,9 %, solution pour perfusion, CHLORURE DE SODIUM FRESENIUS 0,9 %, solution pour perfusion

Primary endpoint: Success rate after Localized Tissue Hydration (LHT) treatment combined with standard care, defined by a reduction in the EVN score of at least 30% between M0 and M6. The EVN is a scale ranging from 0 to 10. It will be completed at the inclusion visit (M0) and at the follow-up visits after the end of treatment (M3 and M6). The primary endpoint will be collected at the M6 follow-up visit.

Source: https://euclinicaltrials.eu/ctis-public/view/2024-510625-25-00